EU clinical trial 2025-523829-17-00: 18F-fluoro-ethyl-tyrosine (18FET) PET for difficult clinical situations in functional pituitary adenoma. A prospective, single arm, single center study. (FET-PIT)
Protocol code: 2025_0205
Sponsor: Centre Hospitalier Universitaire De Lille (Hospital/Clinic/Other health care facility). Phase: Therapeutic exploratory (Phase II). Countries: France (authorised, recruitment pending).
Therapeutic area(s): Analytical, Diagnostic and Therapeutic Techniques and Equipment [E] - Diagnosis [E01]
Gender: Female, Male. Age: 18-64 years, 65+ years. Enrolment: 30.
Status: Authorised, recruitment pending. Decision date: 2026-07-02. Results received: No. Last updated: 2026-07-02.

Condition(s): Patients (male or female) ≥18 years old with Suspected functional pituitary adenoma (prolactinoma, Cushing's disease, acromegaly, thyrotropic adenoma), de novo or recurrence/persistence, With indeterminate pituitary MRI.
Product: IASOglio 2 GBq/mL, solution injectable, IASOglio 2 GBq/mL, solution injectable

Primary endpoint: Prevalence of patients with positive 18FET PET, as determined by consensus among the three readers. PET positivity is defined as focal hyperuptake with an intensity greater than that of healthy cerebral and pituitary background signal.
Endpoint(s): Proportion of patients with a positive 18FET PET scan who received treatment targeting the adenoma (surgery and/or external beam radiation therapy) during the 12-month study period., Proportion of patients with a negative 18FET PET scan who underwent exploratory surgery during the 12-month study period., The proportion of patients who responded to surgery performed during the 12-month study period, as defined by an improvement or normalization of laboratory parameters in accordance with the recommendations specific to each histological subtype., SUVmax, SUVmean, SUVpeak, the ratios of SUVmax in the adenoma to SUVmax in healthy brain tissue and SUVmean in the adenoma to SUVmean in healthy brain tissue, as well as kinetic parameters (activity-time curve, time to peak) measured by 18FET PET., Evaluation of 18FET PET results by histological subtype (prevalence of patients with positive 18FET PET, SUVmax, SUVmean, SUVpeak, the ratios of SUVmax in the adenoma to SUVmax in healthy brain tissue and SUVmean in the adenoma to SUVmean in healthy brain tissue, as well as kinetic parameters [activity-time curve, time to peak] measured by 18FET PET)., Inter-reader agreement in the assessment of 18FET PET positivity, as measured by Krippendorff’s alpha coefficient.

Source: https://euclinicaltrials.eu/ctis-public/view/2025-523829-17-00